EU clinical trial 2025-521144-38-00: The CAROLYN Trial: Lisocabtagene Maraleucel as First-Line Therapy for Primary Central Nervous System Lymphoma (PCNSL) in Transplant-Ineligible Patients
Protocol code: CA082-1215
Sponsor: Bristol-Myers Squibb Services Unlimited Company (Pharmaceutical company). Phase: Therapeutic exploratory (Phase II). Countries: France (ongoing, recruiting), Germany (ongoing, recruiting).
Therapeutic area(s): Diseases [C] - Neoplasms [C04]; Diseases [C] - Nervous System Diseases [C10]
Gender: Female, Male. Age: 18-64 years, 65+ years. Enrolment: 31.
Status: Ongoing, recruiting. Start date (EU): 2025-12-23. Decision date: 2025-10-29. Results received: No. Last updated: 2026-05-06.
Decision dates by country: FR: 2025-10-29, DE: 2025-10-31

Condition(s): Primary Central Nervous System Lymphoma
Product: TEMOZOLOMIDE, TEMOZOLOMIDE, TOCILIZUMAB, CALCIUM FOLINATE, CYCLOPHOSPHAMIDE, RITUXIMAB, Lisocabtagene maraleucel, TEMOZOLOMIDE, PROCARBAZINE, FLUDARABINE, METHOTREXATE, TEMOZOLOMIDE, CALCIUM FOLINATE

Primary endpoint: The proportion of participants in whom the cancer gets worse, or who passed away, within 12 months after getting liso-cel.
Endpoint(s): The time it takes for the cancer to worsen, The time it takes for the participant to start a new cancer treatment, The time it takes for the participants to pass away, after they enroll into the study;, The proportion of participants with no detectable signs of cancer, The proportion of participants with improvement in signs (complete and partial responses), at any time after getting the liso-cel treatment and before the cancer gets worse, they start a new cancer treatment, or the study ends, How long the responses last, How the treatment affects the participants' quality of life, What kinds of health problems participants experience during the study, how severe they are, and how often they happen

Source: https://euclinicaltrials.eu/ctis-public/view/2025-521144-38-00